EU clinical trial 2023-507782-25-00: Efficacy of endothelin receptor antagonism in treatment of coronary artery spasm: a randomized controlled clinical trial.
Protocol code: 114746
Sponsor: Stichting Radboud University Medical Center (Hospital/Clinic/Other health care facility). Phase: Phase II and Phase III (Integrated). Countries: Netherlands (ongoing, recruiting).
Therapeutic area(s): Diseases [C] - Cardiovascular Diseases [C14]
Gender: Female, Male. Age: 18-64 years, 65+ years. Enrolment: 100.
Status: Ongoing, recruiting. Start date (EU): 2024-09-27. Decision date: 2024-04-16. Results received: No. Last updated: 2026-02-25.

Condition(s): Coronary vasomotor dysfunction (spasm), Coronary vasospasm
Product: MIOCHOL-E, Bosentan Abdi 125 mg filmomhulde tabletten, Bosentan Accord 125 mg filmomhulde tabletten, MICROCRYSTALLINE CELLULOSE, Bosentan Accord 62,5 mg filmomhulde tabletten, Bosentan Abdi 62,5 mg filmomhulde tabletten

Primary endpoint: Successful treatment is defined as absence of epicardial vasospasm according to COVADIS criteria (see Table 1 explanatory text in protocol) during repeat spasm provocation test at 10 weeks.
Endpoint(s): Angina relief. The mean within subject change in SAQSS from baseline to 10 weeks is assessed and compared between bosentan and placebo group., Explorative: Anginal complaints and quality of life, Explorative: Microvascular spasm, Explorative: Endothelin levels, Explorative: Improvement, deterioration or no effect on spasm, Explorative safety endpoint: by means of repeat laboratory analysis, blood pressure measurements and the occurrence of major adverse cardiovascular events (MACE), other adverse events (hospitalization for hypotension, angina or myocardial infarction) and rate and reason of study drug discontinuation / study withdrawal

Source: https://euclinicaltrials.eu/ctis-public/view/2023-507782-25-00